EU clinical trial 2024-513091-17-00: Low-dose AtropIne for Myopia control in children
Protocol code: P001307
Sponsor: Medical Center - University Of Freiburg (Hospital/Clinic/Other health care facility). Phase: Therapeutic confirmatory (Phase III). Countries: Germany (ongoing, recruitment ended).
Therapeutic area(s): Diseases [C] - Eye Diseases [C11]
Gender: Female, Male. Age: 0-17 years. Enrolment: 300.
Status: Ongoing, recruitment ended. Start date (EU): 2021-09-29. Decision date: 2024-10-24. Results received: No. Last updated: 2024-10-24.

Condition(s): Progressive myopia
Product: Atropine Sulfate 0.02% eye drops, solution, Atropine Sulfate 0.01% eye drops, solution, Eye drops, solution. Apart from the active substance identical to the IMP.

Primary endpoint: Change of cycloplegic refraction/year [D/year] after 1 year of treatment.
Endpoint(s): Axial eye length change/year [mm/year] after 1 year., Categorized rate of change in refraction and eye length after 1 year.

Source: https://euclinicaltrials.eu/ctis-public/view/2024-513091-17-00